EU clinical trial 2025-522246-43-00: Study in healthy male participants to compare the blood levels after epoetin alfa (Blau EPO) and Erypo, administered as multiple intravenous injections as well as safety, tolerability and the effects on certain blood values.
Protocol code: EPOBLAMD25013
Sponsor: Blau Farmaceutica S.A. (Pharmaceutical company). Phase: Human Pharmacology (Phase I)- Other. Countries: Germany (authorised, recruitment pending).
Therapeutic area(s): Diseases [C] - Hemic and Lymphatic Diseases [C15]
Gender: Male. Age: 18-64 years. Enrolment: 124.
Status: Authorised, recruitment pending. Decision date: 2026-04-02. Results received: No. Last updated: 2026-04-02.

Condition(s): Treatment of symptomatic anemia associated with chronic renal failure:

Source: https://euclinicaltrials.eu/ctis-public/view/2025-522246-43-00